EU clinical trial 2024-518206-40-00: Double-Blind, Placebo-Controlled, Phase 3 Study to Evaluate the Efficacy and Safety of Plozasiran in Adults with Severe Hypertriglyceridemia at High Risk of Acute Pancreatitis (SHASTA-5 Study)
Protocol code: AROAPOC3-3011
Sponsor: Arrowhead Pharmaceuticals Inc. (Pharmaceutical company). Phase: Therapeutic confirmatory (Phase III). Countries: Hungary (ongoing, recruiting), Bulgaria (ongoing, recruiting), Sweden (ongoing, recruiting), Austria (ongoing, recruiting), Norway (authorised, recruitment pending), Belgium (authorised, recruitment pending), Croatia (authorised, recruitment pending), Czechia (authorised, recruitment pending), Latvia (authorised, recruitment pending), Lithuania (authorised, recruitment pending), Spain (authorised, recruitment pending), Slovakia (authorised, recruitment pending).
Therapeutic area(s): Diseases [C] - Nutritional and Metabolic Diseases [C18]
Gender: Female, Male. Age: 18-64 years, 65+ years. Enrolment: 243.
Start date (EU): 2025-11-03. Decision date: 2025-09-23. Results received: No. Last updated: 2026-07-10.
Decision dates by country: SE: 2025-09-23, NO: 2026-06-10, HU: 2025-09-26, BE: 2026-06-01, HR: 2026-06-26, CZ: 2026-06-23, LV: 2026-06-18, LT: 2026-06-04, ES: 2026-06-11, SK: 2026-06-23, BG: 2025-09-29, AT: 2025-09-29

Condition(s): Severe hypertriglyceridemia (SHTG)
Product: ARO-APOC3 PFS, Plozasiran Injection Placebo

Primary endpoint: Time to first occurrence of positively adjudicated AP event (event occurring more than 10 days after the first dose of study drug) compared with placebo during the double-blind treatment period
Endpoint(s): Percent change in fasting serum TG levels from baseline to Month 12 (V9) compared with placebo, Proportion of participants who achieve average fasting TG levels of <880 mg/dL (10 mmol/L) from Month 3 to the end of the double-blind treatment period, Proportion of participants who achieve average fasting TG levels of <500 mg/dL (5.65 mmol/L) from Month 3 to the end of the double-blind treatment period, Time to first occurrence of major abdominal pain event* (event occurring more than 10 days after the first dose of study drug) compared with placebo * Major abdominal pain event defined as any of the following: 1) positively adjudicated AP, or 2) positively adjudicated presentation to emergency room and/or hospitalization with abdominal pain for which no other etiology has been identified, or 3) need to initiate apheresis to decrease TG levels, Change from baseline in patient-reported productivity and activity impairment as assessed by the Work Productivity and Activity Impairment Questionnaire: Specific Health Problem (WPAI SHP) score, Change from baseline in patient-reported health status as assessed by the EuroQol 5-dimension instrument (EQ 5D 5L) score, The frequency and severity of treatment-emergent adverse events (TEAEs) from baseline to end of study (EOS) of each treatment period, Adjudicated MACE event rates

Source: https://euclinicaltrials.eu/ctis-public/view/2024-518206-40-00